EU clinical trial 2023-507589-22-00: A Multicenter, Open-label Phase 1/2 Study of TYRA-300 in Advanced Urothelial Carcinoma and Other Solid Tumors with Activating FGFR3 Gene Alterations (SURF-301)
Protocol code: TYR300-101
Sponsor: Tyra Biosciences Inc. (Pharmaceutical company). Phase: Phase I and Phase II (Integrated)- First administration to humans. Countries: Spain (ended), France (ended), Italy (ended).
Therapeutic area(s): Diseases [C] - Neoplasms [C04]
Gender: Female, Male. Age: 18-64 years, 65+ years. Enrolment: 75.
Status: Ended. Start date (EU): 2023-07-28. End date (EU): 2026-03-03. End date: 2026-03-04. Decision date: 2024-05-17. Results received: No. Last updated: 2025-11-19.
Decision dates by country: FR: 2024-09-27, ES: 2024-05-17, IT: 2025-01-29

Condition(s): Advanced Urothelial Carcinoma and Other Solid Tumors with Activating FGFR3 Gene Alterations

Primary endpoint: Phase 1 (Parts A and B): Incidence of DLT events during the DLT evaluation period (Cycle 1 [28 days])., Phase 2: Investigator-assessed ORR, defined as either a CR or PR by RECIST v1.1.
Endpoint(s): Incidence of AEs characterized by study phase, cohort, seriousness, relationship to study drug, timing, and severity, Changes in clinical laboratory parameters, vital signs, electrocardiogram (ECG) parameters, and physical examination status., Single-dose and steady-state PK parameters, including but not limited to accumulation ratio, Cmax, Tmax, AUC0-last, AUCTau, AUC0-∞(after first dose only), Vd/F, CL/F, and t1/2, Additional secondary endpoint for Phase 1, Part B only: ORR, Additional secondary endpoints for Phase 1, Part B and Phase 2: DOR, DCR, defined as CR, PR, or SD for >12 weeks, TTR., Additional secondary endpoint for Phase 2 only: PFS in Cohorts 1 and 2., Exploratory Endpoint: Biomarkers of TYRA-300 activity, safety, and efficacy. These biomarkers may include, but are not limited to, FGF23, parathyroid hormone, calcitriol, FGF19, and tumor-derived exosomes., Exploratory Endpoint: Evaluate concordance between tissue-based NGS results and ctDNA results from a sponsor-designated central assay for detection of FGFR3 gene alterations in participants enrolled in Cohorts 1 and 2 of Phase 2., Exploratory EndPoint: Estimate OS in Cohorts 1 and 2 of Phase 2.

Source: https://euclinicaltrials.eu/ctis-public/view/2023-507589-22-00